EU clinical trial 2022-500251-22-00: HepaStem Long-Term Safety Registry – Registry for Patients who have been administered HepaStem
Protocol code: PROLONGSTEM
Sponsor: Cellaïon SA (Pharmaceutical company). Phase: Therapeutic exploratory (Phase II). Countries: Spain (ended), Belgium (ended), France (ended), Bulgaria (ended), Poland (ended).
Therapeutic area(s): Diseases [C] - Nutritional and Metabolic Diseases [C18]
Gender: Female, Male. Age: 0-17 years, 18-64 years, 65+ years. Enrolment: 67.
Status: Ended. Start date (EU): 2018-04-12. End date (EU): 2024-05-23. Decision date: 2023-02-03. Results received: Yes. Last updated: 2024-05-21.
Decision dates by country: BG: 2023-03-13, PL: 2023-04-11, BE: 2023-03-02, FR: 2023-02-09, ES: 2023-02-03

Condition(s): This study will include all patients having received at least one infusion of the Investigational Medicinal Product (IMP) HepaStem HALPC during a previous interventional clinical study conducted by Promethera Biosciences or Promethera Therapeutics including patients suffering from urea cycle disorders (UCD), Crigler-Najjar (CN) and Fibroinflammatory liver diseases.
Product: HepaStem

Primary endpoint: To document the occurrence of adverse events of special interest (AESIs) as defined below: • Event with fatal outcome (death) • Organ transplantation and outcome • Development of malignancy or unwanted tissue formation in different organs (tumor development malignant or not) • Disease linked to transmission of adventitious agents or reactivation of latent pathogens • Any adverse event (AE) judged to have a plausible causal relationship to HepaStem.

Source: https://euclinicaltrials.eu/ctis-public/view/2022-500251-22-00